EU clinical trial 2024-518547-38-00: NOTION-4: Prospective study on the impact of different anti-thrombotic therapies on subclinical leaflet thickening and its temporal dynamics in transcatheter bioprosthetic aortic valves.
Sponsor: Rigshospitalet (Hospital/Clinic/Other health care facility). Phase: Therapeutic use (Phase IV). Countries: Denmark (ongoing, recruitment ended).
Therapeutic area(s): Diseases [C] - Cardiovascular Diseases [C14]
Gender: Female, Male. Age: 18-64 years, 65+ years. Enrolment: 350.
Status: Ongoing, recruitment ended. Start date (EU): 2021-05-12. Decision date: 2024-11-11. Results received: No. Last updated: 2025-02-04.

Condition(s): Patients who have undergone successful transcatheter bioprosthetic aortic valve implantation (TAVI)
Product: DABIGATRAN ETEXILATE, DABIGATRAN ETEXILATE, APIXABAN, CLOPIDOGREL, WARFARIN SODIUM, ACETYLSALICYLIC ACID, ACETYLSALICYLIC ACID, RIVAROXABAN, RIVAROXABAN, EDOXABAN, WARFARIN SODIUM, CLOPIDOGREL, EDOXABAN, APIXABAN

Primary endpoint: The number of patients with at least one prosthetic valve leaflet with HALT as assessed by cardiac CT at one year after TAVI.
Endpoint(s): The combined clinical endpoint of all-cause mortality, thromboembolic event, and life-threatening or major bleeding at 1 year, 3 years and 5 years after randomization, The number of patients with at least one prosthetic valve leaflet with HALT as assessed by cardiac CT at 3 months, 1, 3 and 5 years after TAVI, Number of prosthetic leaflets with HALT at CT-scan at 3 months, 1 year, 3 and 5 years., The clinical endpoint of ischemic stroke verified by cerebrovascular imaging after the TAVI-procedure in patients with vs. without HALT., Any type of stroke – including ischemic and hemorrhagic stroke, All-cause mortality, Cardiovascular mortality as defined in current VARC definition, Major bleeding or life-threatening bleeding, Need for re-intervention (valve-in-valve TAVI, paravalvular leak closure, SAVR), Aortic bioprosthetic dysfunction (according to EAPCI/ESC/EACTS definitions), Rate of bioprosthetic valve failure (according to EAPCI/ESC/EACTS definitions), NYHA classification, Quality of life scores

Source: https://euclinicaltrials.eu/ctis-public/view/2024-518547-38-00